EU clinical trial 2023-506214-52-00: Pilot study of safety and efficacy of nicotinamide (vitamin B3) in OPA1 Dominant Optic Atrophy - NICOPA1-TOL
Sponsor: Centre Hospitalier Universitaire D Angers (Hospital/Clinic/Other health care facility). Phase: Therapeutic confirmatory (Phase III). Countries: France (ended).
Therapeutic area(s): Diseases [C] - Nervous System Diseases [C10]
Gender: Female, Male. Age: 18-64 years, 65+ years. Enrolment: 25.
Status: Ended. Start date (EU): 2023-12-27. End date (EU): 2026-04-14. Decision date: 2023-09-13. Results received: No. Last updated: 2024-12-19.

Condition(s): Dominant Optic Atrophy
Product: NICOBION 500 mg, comprimé pelliculé

Primary endpoint: The primary endpoint will be assessed by the number of patients with reported ophthalmological and/or neurological adverse events.
Endpoint(s): Number of patients with improved visual function at follow-up visits compared with baseline at inclusion., Increase in plasma and whole blood nicotinamide levels in all patients, comparing baseline at inclusion with two follow-up periods., Differences on the NEI-VFQ-25 scale between M0 and M6, Clinical neurological improvement at follow-up visits compared with baseline at inclusion.

Source: https://euclinicaltrials.eu/ctis-public/view/2023-506214-52-00